EU clinical trial 2023-505919-21-00: A Phase 2A, Double-blind, Randomized, Placebo-controlled, Multi-center Study to Evaluate the Safety, Tolerability, Pharmacokinetics, and Pharmacodynamics of BMS-986435/MYK-224 in Participants with Heart Failure with Preserved Ejection Fraction (HFpEF)
Protocol code: CV029-1001
Sponsor: Bristol-Myers Squibb Services Unlimited Company (Pharmaceutical company). Phase: Therapeutic exploratory (Phase II). Countries: Spain (ended), Poland (ended), Italy (ended).
Therapeutic area(s): Diseases [C] - Cardiovascular Diseases [C14]
Gender: Female, Male. Age: 18-64 years, 65+ years. Enrolment: 41.
Status: Ended. Start date (EU): 2024-04-25. End date (EU): 2025-01-16. Decision date: 2024-04-15. Results received: No. Last updated: 2024-08-22.
Decision dates by country: IT: 2024-04-17, ES: 2024-04-15, PL: 2024-04-22

Condition(s): Heart failure with preserved ejection fraction (HFpEF)
Product: Placebo for bms-986435-01

Primary endpoint: The main trial endpoint is the number of side effects that occur within the study
Endpoint(s): The secondary trial endpoint is a summary of the amount of MYK-224 in the bloodstream.

Source: https://euclinicaltrials.eu/ctis-public/view/2023-505919-21-00